EU clinical trial 2024-511144-86-00: A Randomised, Double-blind, Placebo-controlled, Multicentre Phase III Study of Olaparib Plus Abiraterone Relative to Placebo Plus Abiraterone as First-line Therapy in Men with Metastatic Castration-resistant Prostate Cancer
Protocol code: PROpel D081SC00001
Sponsor: AstraZeneca AB (Pharmaceutical company). Phase: Therapeutic confirmatory (Phase III). Countries: Czechia (ongoing, recruitment ended), Netherlands (ended), Slovakia (ongoing, recruitment ended), Belgium (ended), Italy (ended), France (ended).
Therapeutic area(s): Diseases [C] - Neoplasms [C04]
Gender: Male. Age: 18-64 years, 65+ years. Enrolment: 183.
Start date (EU): 2019-02-14. Decision date: 2024-03-14. Results received: No. Last updated: 2026-06-03.
Decision dates by country: BE: 2024-03-27, FR: 2024-03-14, IT: 2024-04-22, SK: 2024-03-14, NL: 2024-03-15, CZ: 2024-03-15

Condition(s): Metastatic castration-resistant prostate cancer
Product: ABIRATERONE, PREDNISOLONE, Lynparza 100 mg film-coated tablets, Lynparza 150 mg film-coated tablets

Primary endpoint: Radiological progression free survival (rPFS) defined as the time from randomisation to radiological progression, or death from any cause, whichever occurs first
Endpoint(s): Overall survival (OS), Time to first subsequent anticancer therapy or death (TFST), Time to pain progression (TTPP), Time to first opiate use for cancer-related pain, Time to first symptomatic skeletal-related event (SSRE), Time to second progression or death (PFS2), BPI-SF: progression in pain severity domain, change in pain interference domain, FACT-P total score, FACT-G total score, trial outcome index, functional well-being, physical well being, prostate cancer subscale, and FACT Advanced Prostate Symptom Index 6 (FAPSI 6), HRR gene status, Plasma concentration data at steady state for olaparib, abiraterone, and Δ4-abiraterone in the subset of patients evaluable for PK

Source: https://euclinicaltrials.eu/ctis-public/view/2024-511144-86-00